EU clinical trial 2024-519465-22-01: Functional lung avoidance planning guided by lung perfusion PET/CT versus anatomical planning for lung stereotactic body radiotherapy: a double blinded, randomized, controlled trial
Protocol code: 29BRC23.0220
Sponsor: Centre Hospitalier Regional Et Universitaire De Brest (Hospital/Clinic/Other health care facility). Phase: Therapeutic confirmatory (Phase III). Countries: France (authorised, recruitment pending).
Therapeutic area(s): Diseases [C] - Respiratory Tract Diseases [C08]; Analytical, Diagnostic and Therapeutic Techniques and Equipment [E] - Diagnosis [E01]
Gender: Female, Male. Age: 18-64 years, 65+ years. Enrolment: 418.
Status: Authorised, recruitment pending. Decision date: 2025-10-07. Results received: No. Last updated: 2026-05-04.

Condition(s): planned to be treated in the radiotherapy department of the participating centers with SBRT for primary or secondary lung tumors.
Product: [68Ga]Ga-MAA

Primary endpoint: The primary endpoint is the occurrence of symptomatic RILI (grade≥2 lung toxicity as assessed using the CTCAE 5.0) during the year following lung SBRT. This evaluation will be performed by a medical oncologist blinded from the allocated arm.
Endpoint(s): Quality of life as assessed by the EORTC QLQ-C30,EORTC QLQ-LC29 and EQ-5D-5L questionnaires at 3, 6, 9 and 12 months., - Lung toxicity as assessed using the CTCAE 5.0, RTOG and Late effects in normal tissue-subjective objective management analysis (LENT-SOMA) scales at 3, 6, 9 and 12 months., - Local tumor control., - Progression-free survival at 3, 6, 9 and 12 months., Overall survival at 12 months., Grade 2 or higher lung toxicity as defined for the primary endpoint., Lung perfusion PET/CT imaging at 3 months., To assess the predictive value of the doses delivered to lung functional volumes as compared to the anatomical lung volume on lung perfusion PET/CT imaging at 3 months., To assess the predictive value of the decrease of lung perfusion at 3 months on long term lung toxicity at 12 months.

Source: https://euclinicaltrials.eu/ctis-public/view/2024-519465-22-01